EU clinical trial 2024-518433-29-00: Complexity-enhancing drugs to treat disorders of consciousness (DoC): a ketamine study
Protocol code: V1ComplexitDOC
Sponsor: Universite De Liege, Centre Hospitalier Universitaire De Liege (Educational Institution, Hospital/Clinic/Other health care facility). Phase: Therapeutic exploratory (Phase II). Countries: Belgium (temporarily halted).
Therapeutic area(s): Diseases [C] - Nervous System Diseases [C10]
Gender: Female, Male. Age: 18-64 years, 65+ years. Enrolment: 40.
Status: Temporarily halted. Start date (EU): 2022-01-01. Decision date: 2024-10-08. Results received: No. Last updated: 2025-09-05.

Condition(s): Disorder of Consciousness, severe brain injury
Product: Saline Solution Basi 9 mg/ml solution for infusion, Ketalar 10mg/ml Solution for Injection/Infusion

Primary endpoint: New signs of consciousness (e.g., response to command) measured by the SECONDs., Brain complexity measured by LZC and/or PCI in the ketamine session at the highest dose, compared to placebo and the baseline.
Endpoint(s): The “additional index” (from 0 to 100) of the SECONDs, Baseline fMRI activity in the fronto-parietal network and the thalamo-cortical loop, Baseline metabolic PET level in the fronto-parietal network and the thalamo-cortical loop, EEG alpha connectivity measured via alpha centrality, Spasticity measured via the Modified Ashworth Score, Spasticity measured via EMG recording (H/M ratio), Range of Motion

Source: https://euclinicaltrials.eu/ctis-public/view/2024-518433-29-00